EU clinical trial 2024-517792-20-00: A Single Arm, Open Label Clinical Study of Hematopoietic Stem Cell Gene Therapy with Cryopreserved Autologous CD34+ Cells Transduced with Lentiviral Vector encoding WAS cDNA in Subjects with Wiskott-Aldrich Syndrome (WAS)
Protocol code: OTL-103-4
Sponsor: Fondazione Telethon Ets (Patient organisation/association). Phase: Therapeutic confirmatory (Phase III). Countries: Italy (ongoing, recruiting).
Therapeutic area(s): Diseases [C] - Immune System Diseases [C20]
Gender: Male. Age: 0-17 years, 18-64 years. Enrolment: 9.
Status: Ongoing, recruiting. Start date (EU): 2024-10-29. Decision date: 2024-10-28. Results received: No. Last updated: 2026-03-26.

Condition(s): Wiskott-Aldrich Syndrome
Product: RITUXIMAB, PLERIXAFOR, OTL-103, FLUDARABINE PHOSPHATE, LENOGRASTIM, BUSULFAN

Primary endpoint: Evaluation of the clinical efficacy: • annualized rate of severe infections from 6 to 18 months after gene therapy (GT) compared with 1 year prior to GT; • annualized rate of moderate and severe bleeding episodes up to 1 year after GT compared with 1 year prior to GT.
Endpoint(s): • Evaluation of the overall survival at 12, 24 and 36 months • Evaluation of the safety of treatment: 1) safety and tolerability as measured by adverse event (AE) reporting; 2) absence of malignancy or abnormal clonal proliferation (ACP) development due to insertional oncogenesis; 3) absence of replication-competent lentivirus (RCL). • Evaluation of the engraftment at 6 months • Evaluation of biological correlates of efficacy at 12 months, 2 years and 3 years

Source: https://euclinicaltrials.eu/ctis-public/view/2024-517792-20-00